EU clinical trial 2024-518374-13-00: Effect of siponimod on relevant imaging and immunological hallmarks of progressive multiple sclerosis
Protocol code: SIPO20
Sponsor: Azienda Ospedaliera Universitaria Integrata Verona (Hospital/Clinic/Other health care facility). Phase: Therapeutic use (Phase IV). Countries: Italy (ongoing, recruiting).
Therapeutic area(s): Diseases [C] - Nervous System Diseases [C10]
Gender: Female, Male. Age: 18-64 years, 65+ years. Enrolment: 60.
Status: Ongoing, recruiting. Start date (EU): 2022-02-28. Decision date: 2024-11-05. Results received: No. Last updated: 2024-11-05.

Condition(s): Active progressive multiple sclerosis course after an initial relapse clinical course
Product: Mayzent 0.25 mg film-coated tablets, Mayzent 2 mg film-coated tablets, Mayzent 1 mg film-coated tablets, BAF312, BAF312, BAF312

Primary endpoint: The study endpoint is the change (assumed to be a reduction) of the susceptibility of the rim lesions after treatment with siponimod in comparison to the “natural” change of this parameter during a recent period-time preceding treatment (no later than two years before) with siponimod, so that for each patient an internal comparison will be available.
Endpoint(s): To evaluate the effect of siponimod in reducing the number of SEL comparing to the period prior the treatment (retrospective phase) with the study phase (T3 vs T12 and T3 vs T24)., To describe the individual changes in CSF levels of specific makers of activated microglia/macrophages (sCD14, sCD163, TNF, sTNFR1, sTNFR2, Chitinase 3-1like) and of neuronal/axonal damage (neurofilament-light chains, parvalbumin) from baseline to T24, To evaluate the changes of sCD14, sCD163, TNF, sTNFR1, sTNFR2, Chitinase 3-1like, neurofilament-light chains, and parvalbumin in serum of patients at baseline and at T6, T12, T18, T24, To evaluate the EDSS change between the retrospective phase and the study phase (T0 vs T12 and T12 vs T24, To evaluate changes in cognitive functioning during the two-year study phase (T0-T24), Treatment emergent adverse effect (TEAE) and serious adverse event (SAE) at each follow-up visit

Source: https://euclinicaltrials.eu/ctis-public/view/2024-518374-13-00